EU clinical trial 2023-509615-92-00: Glenzocimab in Anterior stroke with Large Ischemic Core eligible for Endovascular therapy
Sponsor: Hopital Fondation Adolphe De Rothschild (Hospital/Clinic/Other health care facility). Phase: Therapeutic exploratory (Phase II). Countries: France (ended).
Therapeutic area(s): Diseases [C] - Nervous System Diseases [C10]
Gender: Female, Male. Age: 18-64 years, 65+ years. Enrolment: 304.
Status: Ended. End date (EU): 2024-09-02. Decision date: 2024-05-22. Results received: No. Last updated: 2024-05-22.

Condition(s): Ischemic stroke with Large Core
Product: Glenzocimab, GADOVIST 1,0 mmol/mL, solution injectable, 0.9% Sodium Chloride solution

Primary endpoint: Functional outcome at 3 months will be assessed with the modified Rankin Scale (mRS) score dichotomized 0 to 3 versus 4 to 6, collected by phone by trained professionals blinded to the treatment allocation.
Endpoint(s): Proportion of patients with No-reflow (NR) phenomenon on post EVT perfusion imaging (visually demonstrable persistent hypoperfusion on rCBV or rCBF within the infarct lesion on qualitative maps processed according to validated software), Proportion of patients with symptomatic intracranial hemorrhage assessed according to the Heidelberg classification, on a brain CT scan performed between 24-36 hours after EVT, Proportion of patients with any intracranial hemorrhage assessed according to the Heidelberg classification on a brain CT scan performed between 24-36 hours after EVT, All-cause death rate at 3 months, The distribution of mRS score at 3 months (Annex 1), Proportion of patients with favorable functional outcome defined by a modified Rankin Scale score 0-2 at 3 months, Score of the MoCA 5-minutes at 3 months, Incidence of complete recanalization defined by a mTICI score of 2c or 3 on the post-EVT cerebral angiography, Incidence of successful recanalization defined by a mTICI score of 2b, 2c or 3 on the post-EVT cerebral angiography, Proportion of patients with decompressive hemicraniectomy surgery, Proportion of patients with neurological improvement defined by a decrease in NIHSS score > 8 points between the baseline score and the score at 24-36h after EVT, Cerebral infarct volume growth between baseline and 24h brain MRI, The number of EVT passes, Time (in minutes) between the arterial puncture and recanalization occurrence, Incidence of Serious/Non-Serious Adverse Events including bleeding-related events., Cost per additional patient with a mRS 0-3 with glenzocimab use and cost per QALY (Quality adjusted Life Year) gained at 12 months., Proportion of patients with favorable functional outcome defined by a modified Rankin Scale score 0-2 at 12 months, Score of the MoCA 5-minutes at 12 months

Source: https://euclinicaltrials.eu/ctis-public/view/2023-509615-92-00